EU clinical trial 2024-512300-19-00: A randomized, placebo-controlled, double blind trial to study the effects of Etidronate on ectopic CALCIfication in FAhr’s Disease or syndrome: CALCIFADE trial
Protocol code: 22U-0320
Sponsor: Universitair Medisch Centrum Utrecht (Hospital/Clinic/Other health care facility). Phase: Therapeutic exploratory (Phase II). Countries: Netherlands (ongoing, recruiting).
Therapeutic area(s): Diseases [C] - Nervous System Diseases [C10]
Gender: Female, Male. Age: 18-64 years, 65+ years. Enrolment: 98.
Status: Ongoing, recruiting. Start date (EU): 2024-10-03. Decision date: 2024-10-03. Results received: No. Last updated: 2025-01-23.

Condition(s): Fahr's disease, Fahr's syndrome
Product: ETIDRONATE DISODIUM ORAL CAPSULES 400 MG PLACEBO, ETIDRONATE DISODIUM ORAL CAPSULES 400 MG

Primary endpoint: Change in cognitive functioning of patients with Fahr’s disease or syndrome treated with etidronate or placebo between baseline and 12 months after baseline.
Endpoint(s): Change in mobility of patients with Fahr’s disease or syndrome treated with etidronate or placebo between baseline and 12 months after baseline., Change in psychiatric symptoms of patients with Fahr’s disease or syndrome treated with etidronate or placebo between baseline and 12 months after baseline., Change in daily functioning of patients with Fahr’s disease or syndrome treated with etidronate or placebo between baseline and 12 months after baseline., Change in quality of life of patients with Fahr’s disease or syndrome treated with etidronate or placebo between baseline and 12 months after baseline., Change in calcification in the brain of patients with Fahr’s disease or syndrome treated with etidronate or placebo between baseline and 12 months after baseline.

Source: https://euclinicaltrials.eu/ctis-public/view/2024-512300-19-00